EU clinical trial 2024-518172-31-01: ERIS: EGFR-Mutated Lung Cancer in Randomized Investigator-Initiated Study
Sponsor: Region Skane (Hospital/Clinic/Other health care facility). Phase: Therapeutic confirmatory (Phase III). Countries: Sweden (ongoing, recruiting).
Therapeutic area(s): Diseases [C] - Neoplasms [C04]
Gender: Female, Male. Age: 18-64 years, 65+ years. Enrolment: 200.
Status: Ongoing, recruiting. Start date (EU): 2022-06-14. Decision date: 2024-12-02. Results received: No. Last updated: 2024-12-02.

Condition(s): EGFR-mutated non-small cell lung cancer (NSCLC) not amenable for curative treatment intention and candidates for EGFR-inhibitor in first line.
Product: DACOMITINIB, AFATINIB, OSIMERTINIB

Primary endpoint: Progression-free survival (PFS)
Endpoint(s): Time to treatment failure (TTF) of EGFR-inhibitor sequence (total time on TKI), Overall survival (OS), Objective response rate (ORR) in first line and the entire sequence of treatment with EGFR-inhibitors, Disease control rate in (DCR) first line and the entire sequence of treatment with EGFR-inhibitors, Adverse events (AE), Quality of life (QoL) as assessed through Lung Cancer Symptom Scale (LCSS), Tumor-derived cell-free DNA, i.e. ctDNA, will be analyzed in plasma (and in some cases other fluids, e.g. pleural effusion) to search for potential resistance mechanisms to EGFR-TKIs, to identify early progression and to monitor treatment response. The sensitizing EGFR-mutation, EGFR T790M that confer EGFR-TKI resistance and possibly other tumor mutations, or genetic alterations will be analyzed, either alterations detected in pre-treatment tumor tissue or alterations being screened for in liqui, Proximity Extension Analysis (PEA) protein profiling and RNA expression analysis will be performed on tumor tissue. Obtained markers will subsequently be analyzed with exploratory bioinformatics to set up signaling networks possible to follow longitudinally during the disease course. Furthermore, biomarker candidates may be validated as potential drug candidates., Bypass signaling is one reason of TKI-resistance. On tumor biopsies prior treatment, bypass signaling mechanisms with focus on Eph signaling components will be analyzed in situ. Upon relapse, the same reactions will be carried out on re-biopsies and differences will be evaluated in the context of response to EGFR-TKI., Exosomes isolated from plasma and other body fluids will be profiled for mRNA, miRNA and proteins that could be potential key players in resistance mechanisms., Copy number alterations analysis performed on tumor specimen prior treatment and when possible, on tumor re-biopsies at time of progression., Tumor mutational burden (TMB, defined as mutations/megabase) on tumor tissue and potentially on longitudinally assembled blood will be evaluated as a potential marker of resistance and treatment response.

Source: https://euclinicaltrials.eu/ctis-public/view/2024-518172-31-01